EU clinical trial 2023-510153-42-00: NEOadjuvant Abemaciclib and GIredestrant triaL in patients with ER-positive, HER2-negative Early breast cancer
Protocol code: GIM31-Neo-AGILE
Sponsor: Fondazione Oncotech Impresa Sociale (Patient organisation/association). Phase: Therapeutic exploratory (Phase II). Countries: Italy (ongoing, recruitment ended).
Therapeutic area(s): Diseases [C] - Neoplasms [C04]
Gender: Female. Age: 18-64 years, 65+ years. Enrolment: 51.
Status: Ongoing, recruitment ended. Start date (EU): 2024-11-25. Decision date: 2024-08-02. Results received: No. Last updated: 2024-08-02.

Condition(s): ER-positive, HER2-negative Early breast cancer
Product: ABEMACICLIB, RO7197597

Primary endpoint: CCCA rate, defined as the proportion of patients with centrally assessed Ki67 scores ≤ 2.7% in stained biopsies upon treatment at Week 2
Endpoint(s): Percent change in Ki67 expression from baseline to Week 2, ROR score reduction (from baseline to Week 2 and surgery), Clinical and radiologic (magnetic resonance imaging [MRI]) objective responses, Safety endpoints: adverse events and toxicities, according to CTCAE v5.0, also resulting from laboratory tests, vital signs, ECG, ECOG performance status and physical examination, Mechanisms of response and resistance to therapy (translational plan), Correlation between Ki-67% reduction and 18-Fluorothymidine (FLT) uptake reduction, Pathological complete response (pCR) rate (ypT0/is, ypN0) of giredestrant plus abemaciclib

Source: https://euclinicaltrials.eu/ctis-public/view/2023-510153-42-00